EU clinical trial 2023-504930-23-00: A Phase 3, Randomized, Double-blind, Placebo-controlled, Parallel-group Study to Evaluate the Efficacy and Safety of Erenumab in Children (6 to < 12 Years) and Adolescents (12 to < 18 Years) With Episodic Migraine (OASIS PEDIATRIC [EM])
Protocol code: 20150125
Sponsor: Amgen Inc. (Pharmaceutical company). Phase: Therapeutic confirmatory (Phase III). Countries: Germany (ongoing, recruitment ended), Portugal (ongoing, recruitment ended), Italy (ended), Belgium (ongoing, recruitment ended), Spain (ongoing, recruitment ended), Hungary (ended), Poland (ongoing, recruitment ended).
Therapeutic area(s): Diseases [C] - Nervous System Diseases [C10]
Gender: Female, Male. Age: 0-17 years. Enrolment: 233.
Start date (EU): 2019-07-19. Decision date: 2024-07-11. Results received: No. Last updated: 2025-10-16.
Decision dates by country: DE: 2024-07-19, HU: 2024-07-15, PT: 2024-07-12, ES: 2024-07-12, BE: 2024-07-11, IT: 2024-08-26, PL: 2024-07-24

Condition(s): Episodic Migraine
Product: Erenumab, Placebo for AMG 334

Primary endpoint: Change from baseline in MMD to week 9 through week 12 (month 3) of the DBTP.
Endpoint(s): Change from baseline in monthly headache days to week 9 through week 12 (month 3) of the DBTP., Achievement of at least 50% reduction in MMD from baseline to week 9 through week 12 (month 3) of the DBTP, Change from baseline in MMD to the average of the first 3 months (week 1 through week 12) of the DBTP., Change from baseline in monthly average severity of migraine attacks to week 9 through week 12 (month 3) of the DBTP., Change from baseline in migraine related disability and productivity as measured by the modified PedMIDAS to week 9 through week 12 (month 3) of the DBTP.

Source: https://euclinicaltrials.eu/ctis-public/view/2023-504930-23-00